EU clinical trial 2025-522750-39-00: A randomized, phase 3, double-blind, double-dummy, active comparator-controlled multicenter clinical trial to evaluate the efficacy and safety of linaprazan glurate compared to lansoprazole in maintenance of healing in participants with healed erosive esophagitis (EE) due to gastroesophageal reflux disease (GERD) of Los Angeles (LA) grades A to D
Protocol code: CX842A2303
Sponsor: Cinclus Pharma Holding AB (publ) (Pharmaceutical company). Phase: Therapeutic confirmatory (Phase III). Countries: Hungary (ended), Germany (ended), Romania (ended), Bulgaria (ended), Czechia (ended), Poland (ended).
Therapeutic area(s): Diseases [C] - Digestive System Diseases [C06]
Gender: Female, Male. Age: 18-64 years, 65+ years. Enrolment: 96.
Status: Ended. End date (EU): 2026-05-18. End date: 2026-05-19. Decision date: 2026-04-28. Results received: No. Last updated: 2026-05-04.
Decision dates by country: BG: 2026-05-04, CZ: 2026-04-28, DE: 2026-04-29, HU: 2026-05-04, RO: 2026-05-04, PL: 2026-04-30

Condition(s): Erosive esophagitis (EE) due to gastroesophageal reflux disease (GERD)
Product: LANSOPRAZOLE, LANSOPRAZOLE, Placebo to match lansoprazole high dose, Linaprazan glurate, Placebo to match Lansoprazole low dose, Placebo to match Linaprazan Glurate

Primary endpoint: 1.Maintained healing of EE after 24 weeks as assessed by central reading of endoscopy.
Endpoint(s): 1. Maintained healing of EE after 24 weeks as assessed by central reading of endoscopy, 2. Maintained healing from EE as assessed by central reading of endoscopy after 24 weeks in participants with Baseline EE due to GERD of LA grades C/D., 3. Percentage of heartburn-free days from Baseline to Week 24 based on electronic Diary, 4. Maintained healing of EE comparing linaprazan glurate ‘high dose’ with lansoprazole after 52 weeks as assessed by central reading of endoscopy., 5. Maintained healing of EE comparing linaprazan glurate ‘low dose’ with lansoprazole after 52 weeks as assessed by central reading of endoscopy

Source: https://euclinicaltrials.eu/ctis-public/view/2025-522750-39-00